EU clinical trial 2024-518131-11-02: Phase II randomized trial to assess the effect of intensive vs standard adjuvant chemotherapy in localised colon cancer with circulating tumor DNA
Protocol code: CIRCULATE-SPAIN-01
Sponsor: Instituto De Investigacion Sanitaria Fundacion Para La Investigacion Del Hospital Clinico De Valencia-INCLIVA (Hospital/Clinic/Other health care facility). Phase: Therapeutic exploratory (Phase II). Countries: Spain (ongoing, recruitment ended).
Therapeutic area(s): Diseases [C] - Digestive System Diseases [C06]
Gender: Female, Male. Age: 18-64 years, 65+ years. Enrolment: 124.
Status: Ongoing, recruitment ended. Start date (EU): 2025-01-24. Decision date: 2025-01-24. Results received: No. Last updated: 2025-01-24.

Condition(s): Localised Colon Cancer (stage II-III)
Product: Capecitabina KERN PHARMA 150 mg comprimidos recubiertos con película EFG, Oxaliplatin Hospira 5 mg/ml concentrate for solution for infusion, Oxaliplatin Hospira 5 mg/ml concentrate for solution for infusion, Fluorouracilo Accord 50 mg/ml solución inyectable o para perfusión EFG, Irinotecán Hospira 20 mg/mL concentrado para solución para perfusión EFG., Fluorouracilo Accord 50 mg/ml solución inyectable o para perfusión EFG, Fluorouracilo Accord 50 mg/ml solución inyectable o para perfusión EFG, Capecitabina Kern Pharma 300 mg comprimidos recubiertos con película EFG, FOLINATO CÁLCICO NORMON 350 mg Polvo para solución inyectable EFG., Capecitabina KERN PHARMA 500 mg comprimidos recubiertos con película EFG, Irinotecán Hospira 20 mg/mL concentrado para solución para perfusión EFG., Fluorouracilo Accord 50 mg/ml solución inyectable o para perfusión EFG, Oxaliplatin Hospira 5 mg/ml concentrate for solution for infusion, Irinotecán Hospira 20 mg/mL concentrado para solución para perfusión EFG., FOLINATO CÁLCICO NORMON 50 mg Polvo y disolvente para solución inyectable EFG., Fluorouracilo Accord 50 mg/ml solución inyectable o para perfusión EFG

Primary endpoint: Phase IIa: Proportion of patients who negativize ctDNA after treatment., Phase IIb: Proportion of patients who negativize ctDNA after treatment in intensive group versus standard of care.
Endpoint(s): Phase IIb:Disease-free survival comparison between both treatment groups 24 months after treatment., Phase IIb: Disease-free survival comparison between both treatment groups 12 months after treatment., Phase IIb: Proportion of patients treated with triplet combination chemotherapy of FOLFOXIRI presenting adverse events in comparison to conventional adjuvant treatment (CAPOX)., Phase IIb: QLQ-C30 Quality of Life of Cancer Patients and QLQ – CR29, comparison scores between groups at baseline, 3 months and end of treatment.

Source: https://euclinicaltrials.eu/ctis-public/view/2024-518131-11-02